EU clinical trial 2024-510936-31-00: Pharmacokinetics and the Effect of Food on the Pharmacokinetics of TW102 in Healthy Subjects.
Protocol code: TW102-C1.01
Sponsor: Treeway TW001AD B.V. (Pharmaceutical company). Phase: Human Pharmacology (Phase I)- Other. Countries: Portugal (ended).
Therapeutic area(s): Not possible to specify
Gender: Female, Male. Age: 18-64 years. Enrolment: 12.
Status: Ended. Start date (EU): 2024-10-01. End date (EU): 2024-10-18. Decision date: 2024-08-12. Results received: No. Last updated: 2024-09-30.
Decision dates by country: PT: 2024-09-30

Condition(s): No medical condition.

Source: https://euclinicaltrials.eu/ctis-public/view/2024-510936-31-00